EU clinical trial 2022-500929-33-01: An Operationally Seamless Phase 2/3 Randomized, Open-label, Multicenter, Active-Controlled Study to Evaluate the Safety and Efficacy of Bictegravir/Lenacapavir Versus Stable Baseline Regimen in Virologically Suppressed People With HIV-1 on Stable Complex Treatment Regimens
Protocol code: GS-US-621-6289
Sponsor: Gilead Sciences Inc. (Pharmaceutical company). Phase: Phase II and Phase III (Integrated). Countries: Italy (ongoing, recruitment ended), Germany (ongoing, recruitment ended), France (ongoing, recruitment ended), Spain (ongoing, recruitment ended).
Therapeutic area(s): Diseases [C] - Virus Diseases [C02]
Gender: Female, Male. Age: 18-64 years, 65+ years. Enrolment: 129.
Status: Ongoing, recruitment ended. Start date (EU): 2023-05-17. Decision date: 2023-03-31. Results received: No. Last updated: 2026-01-12.
Decision dates by country: IT: 2023-04-03, ES: 2023-03-31, DE: 2023-04-04, FR: 2023-04-03

Condition(s): Human Immunodeficiency Virus (HIV-1) infection
Product: GS-9883 tablets 75 mg, GS-6207 tablets 50 mg, BICTEGRAVIR 75 MG/LENACAPAVIR 50 MG FDC TABLETS, Sunlenca 300 mg film-coated tablets, GS-6207 tablets 25 mg

Primary endpoint: Phase 2: Proportion of participants with HIV-1 RNA ≥ 50 copies/mL at Week 24 as determined by the United States (US) Food and Drug Administration (FDA)-defined snapshot algorithm., Phase 3: Proportion of participants with HIV-1 RNA ≥ 50 copies/mL at Week 48 as determined by the US FDA-defined snapshot algorithm.
Endpoint(s): Phase 2: Proportion of participants with HIV-1 RNA < 50 copies/mL at Week 24 as determined by the US FDA-defined snapshot algorithm., Change from baseline in CD4 cell count at Week 24, Proportion of participants experiencing treatment-emergent adverse events (AEs) through Week 24, PK parameters Cmax, AUCtau, and Ctau (as applicable) of BIC and LEN, Phase 3: Proportion of participants with HIV-1 RNA < 50 copies/mL at Week 48 as determined by the US FDA–defined snapshot algorithm., Change from baseline in CD4 cell count at Weeks 48., Proportion of participants experiencing treatment-emergent AEs through Week 48., Proportion of participants from Treatment Group 1 with HIV-1 RNA ≥ 50 copies/mL at Week 96 as determined by the US FDA-defined snapshot algorithm, Change from baseline in CD4 cell count at Week 96 for participants from Treatment Group 1, Proportion of participants from Treatment Group 1 experiencing treatment-emergent AEs through Week 96

Source: https://euclinicaltrials.eu/ctis-public/view/2022-500929-33-01